EU clinical trial 2024-512355-20-00: Open label, single-center, two-part pharmacokinetic study: Part I: Relative bioavailability study to compare the pharmacokinetics of BP1.4979 after administration of single oral doses of BP1.4979 as sustained release formulation and actual immediate release formulation, under fasting and fed conditions, in healthy subjects. Part II: Pharmacokinetics of BP1.4979 after a 14-day dosing period with b.i.d. administration of BP1.4979 as sustained release formulation in healthy subjects.
Protocol code: BP1.4979 / P24-01
Sponsor: Bioprojet Pharma (Pharmaceutical company). Phase: Human Pharmacology (Phase I)- Other. Countries: Belgium (ended).
Therapeutic area(s): Psychiatry and Psychology [F] - Behavior and Behavior Mechanisms [F01]
Gender: Female, Male. Age: 18-64 years. Enrolment: 32.
Status: Ended. Start date (EU): 2024-08-01. End date (EU): 2024-10-23. Decision date: 2024-06-26. Results received: No. Last updated: 2024-10-24.

Condition(s): Binge eating disorder

Source: https://euclinicaltrials.eu/ctis-public/view/2024-512355-20-00